EU clinical trial 2024-516401-23-00: Comparative Bioavailability of Teriflunomide 14 mg Film-Coated Tablets: A Single-Dose, Open-Label, Randomized, Two-Sequence, Two-Treatment, Two-Period Crossover Study in Healthy Subjects Under Fasting Conditions.
Protocol code: BLCL-TER-PIL01
Sponsor: Tecnimede-Sociedade Tecnico-Medicinal S.A. (Pharmaceutical company). Phase: Human Pharmacology (Phase I)- Bioequivalence Study. Countries: Portugal (ended).
Therapeutic area(s): Not possible to specify
Gender: Male. Age: 18-64 years. Enrolment: 22.
Status: Ended. End date (EU): 2025-09-24. Decision date: 2024-09-04. Results received: No. Last updated: 2024-09-04.

Condition(s): No medical condition.

Source: https://euclinicaltrials.eu/ctis-public/view/2024-516401-23-00